EU clinical trial 2025-522571-28-00: A study to evaluate how well single and multiple doses of O3R-5671-PRO are tolerated in healthy adult subjects
Protocol code: O3R-5671-CL-101
Sponsor: Coultreon Biopharma (Pharmaceutical company). Phase: Human Pharmacology (Phase I)- First administration to humans. Countries: Belgium (ended).
Therapeutic area(s): Diseases [C] - Immune System Diseases [C20]
Gender: Male. Age: 18-64 years. Enrolment: 96.
Status: Ended. Start date (EU): 2025-08-28. End date (EU): 2026-07-20. Decision date: 2025-08-13. Results received: No. Last updated: 2026-07-15.

Condition(s): Inflammatory bowel diseases and psoriasis.

Source: https://euclinicaltrials.eu/ctis-public/view/2025-522571-28-00